EU clinical trial 2024-516728-32-00: A Randomized, Double-Blind, Placebo-Controlled Phase 2/3 Study of BLU-263 in Indolent Systemic Mastocytosis
Protocol code: BLU-263-1201
Sponsor: Blueprint Medicines Corp. (Pharmaceutical company). Phase: Phase II and Phase III (Integrated). Countries: Portugal (ongoing, recruiting), Denmark (ongoing, recruiting), Sweden (ongoing, recruiting), France (ongoing, recruiting), Spain (ongoing, recruiting), Germany (ongoing, recruiting), Belgium (ongoing, recruiting), Austria (ongoing, recruiting), Italy (ongoing, recruiting), Norway (ongoing, recruiting), Netherlands (ongoing, recruiting), Greece (ongoing, recruiting), Czechia (ongoing, recruiting), Ireland (ongoing, recruiting), Poland (ongoing, recruiting).
Therapeutic area(s): Diseases [C] - Neoplasms [C04]; Diseases [C] - Immune System Diseases [C20]
Gender: Female, Male. Age: 18-64 years, 65+ years. Enrolment: 379.
Status: Ongoing, recruiting. Start date (EU): 2021-10-29. Decision date: 2024-11-05. Results received: No. Last updated: 2026-07-08.
Decision dates by country: PT: 2024-12-06, FR: 2024-12-20, DK: 2024-11-11, AT: 2024-11-12, NO: 2024-11-07, SE: 2024-11-06, ES: 2024-11-12, GR: 2026-01-13, CZ: 2026-01-19, IE: 2026-01-23, PL: 2026-01-26, DE: 2024-11-11, NL: 2024-11-05, BE: 2024-11-07, IT: 2024-12-09

Condition(s): Indolent Systemic Mastocytosis and SSM
Product: ELENESTINIB, Placebo tablets, ELENESTINIB, ELENESTINIB, ELENESTINIB

Primary endpoint: Part 1: Safety and tolerability as determined by adverse events, serious treatment-emergent adverse events, and changes in safety laboratory parameters, vital signs, and ECG evaluations PK and PD data The mean change in ISM-SAF TSS from Baseline at Week 13., Part 2: Mean change in ISM-SAF TSS from Baseline to after 48 weeks of treatment (Week 49), as compared to placebo, Part 3: 1. Safety and tolerability determined by AEs, SAEs, and changes in safety laboratory parameters, vital signs, and ECG evaluations. 2. Change in ISM-SAF TSS from elenestinib Baseline (T the last available observation prior to the first dose of elenestinib)
Endpoint(s): Part 1: The mean change in the following measures from Baseline at Week 13: • Serum tryptase; • KIT D816V allele fraction in blood; • BM mast cells. The mean change in ISM-SAF individual symptom scores from Baseline at 12 weeks of treatment (Week 13). The time to achieve a 30% reduction in ISM-SAF TSS, ISM-SAF GSS, ISM-SAF SSS, and ISM-SAF Neurocognitive Symptom Cluster Score from randomization among patients who achieve such a reduction on or before 12 weeks of treatment (Week 13).", Part 2: 1. Proportion of patients achieving a normalized tryptase after 48weeks of treatment (Week 49) as compared to placebo, Part 2: 4. Mean percent change in lumbar BMD from Baseline to after 48 weeks of treatment (Week 49), compared to placebo among patients with baseline osteopenia or osteoporosis, Part 2: 5. Mean change in the annualized rate of anaphylaxis events between the Screening Period and Weeks 25 to 48 of treatment compared to placebo., Part 2: 6. Mean change in QoL score from Baseline to after 48 weeks of treatment (week 49) as compared to placebo., Part 3: 1. Proportion of patients achieving symptom control as defined by achieving mild symptoms 2. Change in ISM-SAF domain scores including the ISM-SAF GSS, ISM-SAF SSS, and ISM-SAF NSS 3. Change in BMD 4. Proportion of patients achieving a normalized tryptase 5. Change in the annualized rate of anaphylaxis events, Part 2 and Part 3 Shared: 1. Change in the following measures: Serum tryptase; KIT D816V allele fraction in blood, and BM mast cells. 2. Proportion of patients achieving controlled disease 3. Change in skin lesions as assessed by the fractional body surface area of the most affected skin area 4. Change in the number of concomitant medications identified as SDT 5. Change in ISM-SAF Individual Symptom Scores 6. Change in ISM-SAF Lead (most severe) Symptom Score, Part 2 and Part 3 Shared (translations continued), Part 2: 2. Proportion of patients achieving an undetectable level or ≥ 50% reduction in KIT D816V-VAF Baseline to after 48 weeks of treatment (Week 49) as compared to placebo among patients with detectable mutation at Baseline, Part 2: 3. Proportion of patients symptom control as defined by achieving mild symptoms after 48 weeks of treatment as compared to placebo.

Source: https://euclinicaltrials.eu/ctis-public/view/2024-516728-32-00